EU clinical trial 2024-518607-21-00: ANtibiotic TReatment OPtimisation – randomised controlled trial of Clostridioides difficile infection therapy (ANTROP-I)
Protocol code: ANTROP-I
Sponsor: Fakultni Nemocnice Bulovka (Hospital/Clinic/Other health care facility). Phase: Therapeutic exploratory (Phase II). Countries: Czechia (ongoing, recruiting).
Therapeutic area(s): Diseases [C] - Bacterial Infections and Mycoses [C01]
Gender: Female, Male. Age: 18-64 years, 65+ years. Enrolment: 244.
Status: Ongoing, recruiting. Start date (EU): 2025-09-25. Decision date: 2025-02-10. Results received: No. Last updated: 2026-02-24.

Condition(s): Clostridioides difficile infection
Product: rice starch, VANCOMYCIN HYDROCHLORIDE

Primary endpoint: The non-inferiority/superiority will be assessed using the incidence of CDI recurrence during 60 days after the end of study treatment as the primary endpoint.
Endpoint(s): Recovery is defined as a sustained clinical improvement in the patient’s overall health status for ≥48 hours, including reduced stool frequency and/or normalisation of consistency, alongside stabilisation or improvement in disease severity parameters (e.g., clinical, laboratory, radiological) and no new severe symptoms. Partial improvements, such as a significant reduction in stool frequency, also reflect treatment efficacy and are perceived as treatment response., 16S rRNA genotypes, The incidence of adverse events, their severity, duration, and relation to vancomycin., EXPLORATORY: Additional stool samples from patients will be collected and stored for future research: a. α-diversity dynamics during the sub-study period b. α-diversity value at the end of treatment c. Identification of main trajectories of microbiota recovery during the sub-study period (species-level) d. Presence of multidrug-resistant bacteria by genetic examination.

Source: https://euclinicaltrials.eu/ctis-public/view/2024-518607-21-00